EU clinical trial 2025-522412-16-00: An Open Label Study to Assess the Effect of Patient Use and Robustness on Tiotropium Bromide Spray 2.5μg, Soft Mist Inhaler device
Protocol code: TioSMI
Sponsor: Laboratorios Liconsa S.A. (Pharmaceutical company). Phase: Human Pharmacology (Phase I)- Other. Countries: Spain (authorised, recruitment pending).
Therapeutic area(s): Diseases [C] - Respiratory Tract Diseases [C08]
Gender: Female, Male. Age: 18-64 years, 65+ years. Enrolment: 75.
Status: Authorised, recruitment pending. Decision date: 2025-09-16. Results received: No. Last updated: 2026-07-14.

Condition(s): Chronic obstructive pulmonary disease

Source: https://euclinicaltrials.eu/ctis-public/view/2025-522412-16-00